EU clinical trial 2024-516473-72-00: A Phase 3, Randomized, Double-Blinded, Double-Dummy Study Evaluating the Efficacy and Safety of Empasiprubart Versus Intravenous Immunoglobulin in Adults With Multifocal Motor Neuropathy.
Protocol code: ARGX-117-2302
Sponsor: Argenx (Pharmaceutical company). Phase: Therapeutic confirmatory (Phase III). Countries: Slovenia (ended), Estonia (ended), Greece (ongoing, recruitment ended), Portugal (ended), Slovakia (ongoing, recruitment ended), Czechia (ongoing, recruitment ended), Germany (ongoing, recruitment ended), Lithuania (ongoing, recruitment ended), Netherlands (ongoing, recruitment ended), Italy (ongoing, recruitment ended), Austria (ongoing, recruitment ended), France (ongoing, recruitment ended), Belgium (ongoing, recruitment ended), Sweden (ended), Poland (ongoing, recruitment ended), Norway (ongoing, recruitment ended), Spain (ongoing, recruitment ended), Latvia (ongoing, recruitment ended), Denmark (ongoing, recruitment ended).
Therapeutic area(s): Diseases [C] - Musculoskeletal Diseases [C05]; Diseases [C] - Nervous System Diseases [C10]
Gender: Female, Male. Age: 18-64 years, 65+ years. Enrolment: 134.
Start date (EU): 2025-07-31. Decision date: 2025-07-14. Results received: No. Last updated: 2026-06-01.
Decision dates by country: CZ: 2025-07-16, NO: 2025-07-25, NL: 2025-07-17, AT: 2025-07-21, SI: 2025-07-15, LV: 2025-07-25, DK: 2025-07-25, SK: 2025-07-16, PL: 2025-07-25, LT: 2025-07-17, GR: 2025-07-15, ES: 2025-07-25, BE: 2025-07-25, PT: 2025-07-15, SE: 2025-07-25, EE: 2025-07-16, FR: 2025-07-25, DE: 2025-07-16, IT: 2025-07-18

Condition(s): Multifocal Motor Neuropathy
Product: HUMAN NORMAL IMMUNOGLOBULIN (IV), Placebo solution for IV infusion, ARGX-117, Placebo solution for IV infusion, HUMAN NORMAL IMMUNOGLOBULIN (IV)

Primary endpoint: Change from baseline in GS (3 day moving average) in the most affected hand at week 24
Endpoint(s): Part A - Change from baseline in MMN-RODS centile score at week 24, Part A - Change from baseline in mMRC-14 sum score at week 24, Part A - PGI-C actual value over time, Part A - Change from baseline in CAP-PRI total score over time, Part A - Percentage change from baseline in time to complete the 9-HPT with the dominant hand at week 24, Part A - Incidence and severity of AEs and AESIs, Incidence of SAEs, Part A - Clinically meaningful changes in laboratory parameters, vital signs, and ECG results, Part A - Serum concentrations over time and PK parameters of empasiprubart, Part A - Values and percentage change from baseline in free C2 and total C2 over time, Part A - Incidence and prevalence of anti-drug antibodies (ADA) against empasiprubart in serum, Part A - Incidence and prevalence of NAb against empasiprubart in serum, Part A - Change from baseline in GS (3-day moving average) of the least affected hand over time and AUC of change from baseline in GS (daily average) for both hands; percentage change from baseline in GS (3-day moving average) for both hands, Part A - Percentage change from baseline in time to complete the 9-HPT with the nondominant hand over time, Part A - Change from baseline in sum scores for mMRC-10 and mMRC-14 restricted to the 2 most affected muscle groups over time, Part A - Proportion of participants and shift from baseline over time by level of severity on PGI-S, Part A - Change from baseline in Rasch-Transformed Fatigue Severity Scale (RT-FSS) score over time, Part A - Change from baseline in physical component and mental component scores of 12-Item Short Form Survey (SF-12) over time, Part A - Proportion of participants and shift from baseline by each dimension of the EQ5D-5L scale, change from baseline in the EQ-5D-5L visual analog scale over time, and change from baseline in EQ-5D-5L valuation index, Part B - Actual values of and changes from baseline in MMN-RODS centile score, CAPPRI total score, grip strength (daily average; both hands), mMRC-10 sum score, mMRC-14 sum score, and mMRC-14 sum score restricted to the 2 most affected muscle groups over time, Part B - Actual values of and percentage change from baseline in time to complete the 9-HPT with the dominant and nondominant hands over time, Part B - Actual values of PGI-C and PGI-S over time, Part B - Incidence and severity of AEs and AESIs, Incidence of SAEs, Part B - Clinically meaningful changes in laboratory parameters, vital signs, and ECG results, Part B - Serum concentrations over time and PK parameters of empasiprubart, Part B - Values and percentage change from baseline in free C2 and total C2 over time, Part B - Incidence and prevalence of ADA against empasiprubart in serum, Part B - Incidence and prevalence of NAb against empasiprubart in serum, Part B - Change from baseline in RT-FSS score over time, Part B - Change from baseline in physical component and mental component scores of SF-12 over time, Part B - Proportion of participants and shift from baseline by each dimension of the EQ5D-5L scale and change from baseline in the EQ-5D-5L visual analog scale over time

Source: https://euclinicaltrials.eu/ctis-public/view/2024-516473-72-00